EU clinical trial 2023-510307-22-00: A study to test BI 765179 alone and in combination with ezabenlimab in patients with advanced cancer (solid tumors) and BI 765179 in combination with pembrolizumab in patients with advanced head and neck cancer
Protocol code: 1463-0001
Sponsor: Boehringer Ingelheim International GmbH, Boehringer Ingelheim Espana S.A. (Pharmaceutical company). Phase: Human Pharmacology (Phase I)- First administration to humans. Countries: Italy (ended), Netherlands (ongoing, recruitment ended), Belgium (ended), Spain (ongoing, recruitment ended), Czechia (ended), France (ongoing, recruitment ended), Germany (ongoing, recruitment ended).
Therapeutic area(s): Diseases [C] - Neoplasms [C04]
Gender: Female, Male. Age: 18-64 years, 65+ years. Enrolment: 111.
Start date (EU): 2021-09-24. Decision date: 2024-03-11. Results received: No. Last updated: 2026-04-07.
Decision dates by country: IT: 2024-03-18, BE: 2024-03-27, FR: 2025-04-10, NL: 2024-03-11, ES: 2024-03-11, CZ: 2025-04-22, DE: 2025-04-10

Condition(s): Advanced head and neck cancer

Source: https://euclinicaltrials.eu/ctis-public/view/2023-510307-22-00